EU clinical trial 2023-509645-12-00: MK-4318 CIDF Target Engagement Study
Protocol code: MK-4318-005
Sponsor: Merck Sharp & Dohme LLC (Pharmaceutical company). Phase: Human Pharmacology (Phase I)- Other. Countries: Belgium (ended).
Therapeutic area(s): Diseases [C] - Nervous System Diseases [C10]
Gender: Male. Age: 18-64 years. Enrolment: 16.
Status: Ended. Start date (EU): 2024-04-12. End date (EU): 2024-08-06. End date: 2024-08-07. Decision date: 2024-04-09. Results received: No. Last updated: 2024-04-09.

Condition(s): Pain

Source: https://euclinicaltrials.eu/ctis-public/view/2023-509645-12-00